EU clinical trial 2023-509821-29-00: Cabozantinib plus Durvalumab in patients with advanced and chemotherapy-treated bladder carcinoma, of urothelial and non-urothelial histology: an open-label, single-centre, phase 2, single-arm proof-of-concept trial: ARCADIA study
Sponsor: Fondazione IRCCS Istituto Nazionale Dei Tumori (Hospital/Clinic/Other health care facility). Phase: Therapeutic exploratory (Phase II). Countries: Italy (ongoing, recruiting).
Therapeutic area(s): Diseases [C] - Neoplasms [C04]
Gender: Female, Male. Age: 18-64 years, 65+ years. Enrolment: 122.
Status: Ongoing, recruiting. Start date (EU): 2019-09-25. Decision date: 2024-02-23. Results received: No. Last updated: 2026-08-03.

Condition(s): bladder carcinoma of urothelial and non-urothelial histology
Product: CABOMETYX 20 mg film-coated tablets, IMFINZI 50 mg/mL concentrate for solution for infusion., IMFINZI 50 mg/mL concentrate for solution for infusion., CABOMETYX 20 mg film-coated tablets, CABOMETYX 40 mg film-coated tablets, CABOMETYX 40 mg film-coated tablets, CABOMETYX 40 mg film-coated tablets, CABOMETYX 20 mg film-coated tablets, CABOMETYX 40 mg film-coated tablets, IMFINZI 50 mg/mL concentrate for solution for infusion., CABOMETYX 20 mg film-coated tablets, IMFINZI 50 mg/mL concentrate for solution for infusion.

Primary endpoint: The primary endpoint of the study will be overall survival (OS).
Endpoint(s): To assess OS in patients with bone metastases only., To assess OS in patients with pure non-urothelial histology., Assessment of RR (investigator-assessed) according to the Response Evaluation Criteria in Solid Tumors (RECIST) v1.1 criteria. RR (%) = complete (CR) + partial responses (PR)., Assessment of RR according to the immune-related RECIST criteria., FDG-PET response in bone metastases (EORTC criteria)., Response duration (including stable diseases [SD])., Progression-Free Survival (investigator-assessed)., Correlative biological/immunologic endpoints.

Source: https://euclinicaltrials.eu/ctis-public/view/2023-509821-29-00